EU clinical trial 2023-504507-81-00: A bicentric, randomized, double blind, placebo-controlled pilot study to evaluate the efficacy and safety of satralizumab in FSHD1
Protocol code: 22-PP-24
Sponsor: Centre Hospitalier Universitaire De Nice (Hospital/Clinic/Other health care facility). Phase: Therapeutic exploratory (Phase II). Countries: France (ongoing, recruitment ended).
Therapeutic area(s): Diseases [C] - Nervous System Diseases [C10]
Gender: Female, Male. Age: 18-64 years, 65+ years. Enrolment: 34.
Status: Ongoing, recruitment ended. Start date (EU): 2024-01-15. Decision date: 2023-09-15. Results received: No. Last updated: 2026-05-27.

Condition(s): Type 1 facioscapulohumeral muscular dystrophy
Product: Enspryng 120 mg solution for injection in pre-filled syringe, Placebo is identical in composition to satralizumab but does not contain the satralizumab active ingredient. For details, please see the Q-IMPD submission performed by Roche (EU CT : 2023-506569-73-00)

Primary endpoint: The study will evaluate the efficacy of satralizumab compared to placebo, measured by the change during the Double Blind (DB) period (week 0 to week 48) on whole body muscle MRI., The study will evaluate the efficacy of satralizumab compared to placebo, measured by the change during the Double Blind (DB) period (week 0 to week 48) on RICCI clinical severity scale score., The study will evaluate the efficacy of satralizumab compared to placebo, measured by the change during the Double Blind (DB) period (week 0 to week 48) on Reachable Work Space (RWS) results with and without weights., The study will evaluate the efficacy of satralizumab compared to placebo, measured by the change during the Double Blind (DB) period (week 0 to week 48) on muscle strength, determined by quantitative isometric dynamometry., The study will evaluate the efficacy of satralizumab compared to placebo, measured by the change during the Double Blind (DB) period (week 0 to week 48) on FSHD-Composite Outcome Measure (FSHD-COM) total score, sub-scale scores and individual items., The study will evaluate the efficacy of satralizumab compared to placebo, measured by the change during the Double Blind (DB) period (week 0 to week 48) on FSHD-Rasch-built overall disability scale (FSHD-RODS) total score., The study will evaluate the efficacy of satralizumab compared to placebo, measured by the proportion of participants with an improvement in the FSHD Patient Global Impression of Change scale (FSHD-PGIC) during the Double Blind (DB) period (week 0 to week 48), The study will evaluate the efficacy of satralizumab compared to placebo, measured by the proportion of participants with an improvement in the FSHD Clinical Global Impressions of Change scale (FSHD-CGIC) during the Double Blind (DB) period (week 0 to week 48), The study will evaluate the efficacy of satralizumab compared to placebo, measured by the change during the Double Blind (DB) period (week 0 to week 48) on the number of falls reported., The study will evaluate the efficacy of satralizumab compared to placebo, measured by the change during the Double Blind (DB) period (week 0 to week 48) on Neuromuscular Disease Independence Scale-Upper Limb Module (NMDIS-ULM) total score., The study will evaluate the efficacy of satralizumab compared to placebo, measured by the change during the Double Blind (DB) period (week 0 to week 48) on Neuromuscular Disease Independence Scale-Ambulatory (NMDIS-Amb) total score., The study will evaluate the efficacy of satralizumab compared to placebo, measured by the change during the Double Blind (DB) period (week 0 to week 48) on inflammation, and specifically on molecular biomarkers associated with inflammation (e.g. IFN-γ, IL-1β, IL-6, TNF-α, VEGF, IL1-RA, IL-6-R, sICAM-1, sVCAM-1, SAA…)., The study will evaluate the safety and tolerability of satralizumab compared to placebo, measured by the type, frequency, severity, seriousness, and relationship of Adverse Events (AEs) to satralizumab during the Double Blind (DB) period (week 0 to week 48)., The study will evaluate the safety and tolerability of satralizumab compared to placebo, measured by the incidence of Adverse events of special interest (AESIs) and selected AEs during the Double Blind (DB) period (week 0 to week 48)., The study will evaluate the safety and tolerability of satralizumab compared to placebo, measured by the number of subjects discontinuing study drug due to an AE during the Double Blind (DB) period (week 0 to week 48)., The study will evaluate the safety and tolerability of satralizumab compared to placebo, measured by the frequency of clinically significant changes from baseline in laboratory test, vital signs, and physical examination results during the Double Blind (DB) period (week 0 to week 48).
Endpoint(s): The study will evaluate the efficacy of satralizumab compared to placebo, measured by the change during Double Blind (DB) and Open-label (OL) periods (week 0 to week 96) on whole body muscle MRI., The study will evaluate the efficacy of satralizumab compared to placebo, measured by the change during Double Blind (DB) and Open-label (OL) periods (week 0 to week 96) on RICCI clinical severity scale score., The study will evaluate the efficacy of satralizumab compared to placebo, measured by the change during Double Blind (DB) and Open-label (OL) periods (week 0 to week 96) on Reachable Work Space (RWS) results with and without weights., The study will evaluate the efficacy of satralizumab compared to placebo, measured by the change during Double Blind (DB) and Open-label (OL) periods (week 0 to week 96) on muscle strength, determined by quantitative isometric dynamometry., The study will evaluate the efficacy of satralizumab compared to placebo, measured by the change during Double Blind (DB) and Open-label (OL) periods (week 0 to week 96) on FSHD-Composite Outcome Measure (FSHD-COM) total score, sub-scale scores and individual items., The study will evaluate the efficacy of satralizumab compared to placebo, measured by the change during Double Blind (DB) and Open-label (OL) periods (week 0 to week 96) on FSHD-Rasch-built overall disability scale (FSHD-RODS) total score., The study will evaluate the efficacy of satralizumab compared to placebo, measured by the proportion of participants with an improvement in the FSHD Patient Global Impression of Change scale (FSHD-PGIC) during Double Blind (DB) and Open-label (OL) periods (week 0 to week 96), The study will evaluate the efficacy of satralizumab compared to placebo, measured by the proportion of participants with an improvement in the FSHD Clinical Global Impressions of Change scale (FSHD-CGIC) during Double Blind (DB) and Open-label (OL) periods (week 0 to week 96), The study will evaluate the efficacy of satralizumab compared to placebo, measured by the change during Double Blind (DB) and Open-label (OL) periods (week 0 to week 96) on the number of falls reported., The study will evaluate the efficacy of satralizumab compared to placebo, measured by the change during Double Blind (DB) and Open-label (OL) periods (week 0 to week 96) on Neuromuscular Disease Independence Scale-Upper Limb Module (NMDIS-ULM) total score., The study will evaluate the efficacy of satralizumab compared to placebo, measured by the change during Double Blind (DB) and Open-label (OL) periods (week 0 to week 96) on Neuromuscular Disease Independence Scale-Ambulatory (NMDIS-Amb) total score, The study will evaluate the efficacy of satralizumab compared to placebo, measured by the change during Double Blind (DB) and Open-label (OL) periods (week 0 to week 96) on inflammation, and specifically on molecular biomarkers associated with inflammation (e.g. IFN-γ, IL-1β, IL-6, TNF-α, VEGF, IL1-RA, IL-6-R, sICAM-1, sVCAM-1, SAA…)., The study will evaluate the safety and tolerability of satralizumab compared to placebo, measured by the type, frequency, severity, seriousness, and relationship of Adverse Events (AEs) to satralizumab during Double Blind (DB) and Open-label (OL) periods (week 0 to week 96), The study will evaluate the safety and tolerability of satralizumab compared to placebo, measured by the incidence of Adverse events of special interest (AESIs) and selected AEs during Double Blind (DB) and Open-label (OL) periods (week 0 to week 96), The study will evaluate the safety and tolerability of satralizumab compared to placebo, measured by the number of subjects discontinuing study drug due to an AE during Double Blind (DB) and Open-label (OL) periods (week 0 to week 96), The study will evaluate the safety and tolerability of satralizumab compared to placebo, measured by the frequency of clinically significant changes from baseline in laboratory test, vital signs, and physical examination results during Double Blind (DB) and Open-label (OL) periods (week 0 to week 96)

Source: https://euclinicaltrials.eu/ctis-public/view/2023-504507-81-00